EU clinical trial 2025-520757-36-00: REDO-JAK: Dose REDuction Of JAnus Kinase inhibitors in patients with inflammatory rheumatic diseases
Protocol code: T1172
Sponsor: Sint Maartenskliniek Stichting (Hospital/Clinic/Other health care facility). Phase: Therapeutic use (Phase IV). Countries: Netherlands (ongoing, recruiting).
Therapeutic area(s): Diseases [C] - Musculoskeletal Diseases [C05]
Gender: Female, Male. Age: 18-64 years, 65+ years. Enrolment: 200.
Status: Ongoing, recruiting. Start date (EU): 2025-09-15. Decision date: 2025-07-01. Results received: No. Last updated: 2026-01-13.

Condition(s): Rheumatoid arthritis, psoriatic arthritis and axial spondyloarthritis
Product: XELJANZ 11 mg prolonged-release tablets, Olumiant 2 mg film-coated tablets, Jyseleca 200 mg film-coated tablets, XELJANZ 5 mg film-coated tablets, RINVOQ 15 mg prolonged-release tablets, Jyseleca 100 mg film-coated tablets, Olumiant 4 mg film-coated tablets

Primary endpoint: The proportion of patients in low disease activity (LDA) at 12 months of follow-up in each study group. LDA is defined as DAS28-CRP < 2.9 for RA patients, PASDAS < 3.2 and mBSA involvement ≤3% for PsA and ASDAS < 2.1 and an absence of active extra musculoskeletal symptoms for axSpA.
Endpoint(s): Mean DAS28-CRP for RA patients, PASDAS for PsA patients and ASDAS for AxSpA patients at 6 and 12 months of follow up in each study group., Proportion of patients in intervention group at every dose reduction step (including discontinuation) at 6 and 12 months of follow up., The proportion (cumulative incidence and incidence density) of patients developing (treatment-related) adverse events in each study group over the duration of the study, with special attention to infections, anaemia, cardiovascular events, VTE and malignancies., The cumulative incidence of patients experiencing a flare in each study group over the duration of the study., Proportion of patients using csDMARD, corticosteroids or NSAIDs at baseline, and starting/changing these treatments during follow-up., Quality of life and costs incurred during the study will be compared between the study groups. The incremental cost effectiveness ratio will be calculated using incremental (between-group) costs and quality of life, and compared with different willingness to pay thresholds., Association between possible predictors and outcome. Predictors will include baseline peak and trough JAKi concentrations and whole blood/PBMC immunophenotyping

Source: https://euclinicaltrials.eu/ctis-public/view/2025-520757-36-00